EU clinical trial 2022-503160-33-00: A Randomized, Double-blind, Placebo-controlled, Multicenter, Phase 3 Study to Evaluate the Efficacy and Safety of Izokibep in Subjects with Moderate to Severe Hidradenitis Suppurativa
Protocol code: 22107
Sponsor: Acelyrin Inc. (Pharmaceutical company). Phase: Therapeutic confirmatory (Phase III). Countries: Hungary (ended), France (ended), Spain (ended), Germany (ended), Poland (ended).
Therapeutic area(s): Diseases [C] - Skin and Connective Tissue Diseases [C17]
Gender: Female, Male. Age: 18-64 years, 65+ years. Enrolment: 68.
Status: Ended. Start date (EU): 2023-12-15. End date (EU): 2025-01-27. End date: 2025-01-28. Decision date: 2023-11-13. Results received: Yes. Last updated: 2024-12-04.
Decision dates by country: HU: 2023-11-17, PL: 2023-11-28, FR: 2023-11-13, ES: 2023-11-13, DE: 2023-11-16

Condition(s): Hidradenitis Suppurativa
Product: Placebo, Izokibep

Primary endpoint: HiSCR75 at Week 12
Endpoint(s): HiSCR90 at Week 12 • HiSCR100 at Week 12 • HiSCR50 at Week 12• HS flares through Week 12 • Change in DLQI from baseline to Week 12 • AN count of 0, 1, or 2 at Week 12 • Change from baseline in NRS in Patient Global Assessment of Skin Pain at its worst at Week 12 • TEAEs and SAEs • Laboratory values and vital signs at collected timepoints

Source: https://euclinicaltrials.eu/ctis-public/view/2022-503160-33-00